EU clinical trial 2024-511212-24-00: An Open-label, Phase I/II Multicenter Clinical Trial of NECVAX-NEO1 in Addition to Anti-PD-1 or Anti-PD-L1 Monoclonal Antibody Therapy in Patients with Solid Tumors (NECVAX-NEO1-02-INT).
Protocol code: NECVAX-NEO1-02-INT
Sponsor: NEC Bio Therapeutics GmbH (Pharmaceutical company). Phase: Phase I and Phase II (Integrated)- Other. Countries: Lithuania (ongoing, recruitment ended), Germany (ongoing, recruitment ended), Spain (ongoing, recruitment ended).
Therapeutic area(s): Not possible to specify
Gender: Female, Male. Age: 18-64 years, 65+ years. Enrolment: 40.
Status: Ongoing, recruitment ended. Start date (EU): 2024-10-07. Decision date: 2024-08-08. Results received: No. Last updated: 2025-11-21.
Decision dates by country: ES: 2024-08-12, LT: 2024-08-08, DE: 2024-08-09

Condition(s): Advanced solid tumors

Primary endpoint: Reported adverse events (AEs) and serious adverse events (SAEs)., Changes from Baseline in laboratory parameters (hematology, biochemistry, coagulation, and urinalysis), physical examinations, vital signs, and electrocardiograms (ECGs) during the Treatment and Follow-up periods.
Endpoint(s): Changes from baseline in circulating tumor DNA (ctDNA) assessments., Clinical efficacy endpoints will be determined using RECIST 1.1 and iRECIST: • Objective response rate (ORR): Cohort 1: The proportion of patients having a best overall response (BOR) of complete response (CR) or partial response (PR) relative to assessment at the Screening visit. Cohort 2: The proportion of patients having a BOR of CR or PR relative to the baseline assessment (prior to administration of NECVAX-NEO1)., Progression-free-survival (PFS), defined as the time from first NECVAX-NEO1 administration to the first of progressive disease (PD) or death., Time-to-Progression (TTP), defined as the time from first NECVAX-NEO1 administration to PD., Additional clinical outcomes: • Overall survival (OS), defined as the time from first NECVAX-NEO1 administration to death.

Source: https://euclinicaltrials.eu/ctis-public/view/2024-511212-24-00